EU clinical trial 2022-502200-67-00: An Open-label, Randomized, Three-period, Crossover Study to compare the Pharmacokinetics of GB1211 upon dosing a capsule under fasting condition and a tablet under fasting and fed conditions in healthy volunteers.
Protocol code: GB1211-CPH-005
Sponsor: Galecto Biotech AB (Pharmaceutical company). Phase: Human Pharmacology (Phase I)- Other. Countries: Netherlands (ended).
Therapeutic area(s): Diseases [C] - Digestive System Diseases [C06]; Diseases [C] - Neoplasms [C04]
Gender: Female, Male. Age: 18-64 years. Enrolment: 12.
Status: Ended. Start date (EU): 2022-12-27. End date (EU): 2023-04-10. Decision date: 2022-12-20. Results received: Yes. Last updated: 2023-04-04.

Condition(s): Non-small Cell Lung Cancer, Advanced liver Fibrosis and Cirrhosis
Product: 5-Bromopyridin-3-yl 3-deoxy-3-[4-(3,4,5-trifluorophenyl)-1H-1,2,3-triazol-1-yl]-1-thio-α-D-galactopyranoside, 5-Bromopyridin-3-yl 3-deoxy-3-[4-(3,4,5-trifluorophenyl)-1H-1,2,3-triazol-1-yl]-1-thio-α-D-galactopyranoside

Primary endpoint: Plasma PK parameters including but not limited to: AUC0-last, AUC0-inf, Cmax, Tmax, CL/F, Vz/F and urine PK parameters including but not limited to Ae and Fe.
Endpoint(s): Safety and tolerability parameters including: physical examination, weight, AEs, clinical laboratory values, vital signs and 12-lead ECGs.

Source: https://euclinicaltrials.eu/ctis-public/view/2022-502200-67-00